EU clinical trial 2024-512575-12-00: A Phase 1/2, first-in-human, two-part, open-label clinical trial of intravenous administration of CTL-002 given as monotherapy and/or in combination with an anti-PD-1 checkpoint inhibitor in subjects with advanced-stage, relapsed/refractory solid tumors.
Protocol code: CTL-002-001
Sponsor: CatalYm GmbH (Pharmaceutical company). Phase: Phase I and Phase II (Integrated)- Other. Countries: Germany (ongoing, recruitment ended), Spain (ongoing, recruitment ended).
Therapeutic area(s): Diseases [C] - Neoplasms [C04]; Diseases [C] - Immune System Diseases [C20]
Gender: Female, Male. Age: 18-64 years, 65+ years. Enrolment: 169.
Status: Ongoing, recruitment ended. Start date (EU): 2020-11-25. Decision date: 2024-07-03. Results received: No. Last updated: 2026-06-22.
Decision dates by country: DE: 2024-07-12, ES: 2024-07-03

Condition(s): ADVANCED-STAGE, RELAPSED/REFRACTORY SOLID TUMORS
Product: Visugromab (CTL-002), OPDIVO 10 mg/mL concentrate for solution for infusion., OPDIVO 10 mg/mL concentrate for solution for infusion., OPDIVO 10 mg/mL concentrate for solution for infusion., OPDIVO 10 mg/mL concentrate for solution for infusion., LIBTAYO 350 mg concentrate for solution for infusion.

Primary endpoint: Evaluation of the clinical efficacy according to RECIST V1.1 of CTL-002 in combination with an anti-PD-1 checkpoint inhibitor by assessment of: o The proportion of participants with tumor shrinkage (defined as reduction in sum of diameters of target lesions ≥ -5%), a confirmed PR and/or CR, and ORR. o The interval between the date of first CTL-002 administration and first documented evidence of a PR or CR (TTR). See protocol, Evaluation of the number of participants with AEs, including SAEs, clinical laboratory data, vital signs, ECGs, physical examination (including neurological assessment), and ECOG performance status.
Endpoint(s): Evaluation of PK parameters of CTL-002 (e.g., Cmax, AUC, and t1/2)., Evaluation of treatment-emergent cytokine and chemokine profiles in peripheral blood., Evaluation of treatment-induced ADA., Evaluation of GDF-15 serum levels and their correlation with pharmacodynamics and clinical response., To assess muscle mass (e.g., L3 skeletal muscle index [L3SMI]).

Source: https://euclinicaltrials.eu/ctis-public/view/2024-512575-12-00